EU clinical trial 2023-507009-32-00: A Global Multicenter, Randomized, Double-blinded, Propofol-controlled, Phase 3 Clinical Study to Evaluate the Efficacy and Safety of HSK3486 Injectable Emulsion for Induction of General Anesthesia in Adults Undergoing Elective Surgery
Protocol code: HSK3486-309
Sponsor: Haisco-USA Pharmaceuticals Inc. (Pharmaceutical company). Phase: Therapeutic confirmatory (Phase III). Countries: Spain (ended), Poland (ended).
Therapeutic area(s): Analytical, Diagnostic and Therapeutic Techniques and Equipment [E] - Anesthesia and Analgesia [E03]
Gender: Female, Male. Age: 18-64 years, 65+ years. Enrolment: 140.
Status: Ended. Start date (EU): 2024-05-08. End date (EU): 2024-07-11. End date: 2024-07-23. Decision date: 2024-02-12. Results received: Yes. Last updated: 2024-06-21.
Decision dates by country: PL: 2024-05-20, ES: 2024-02-12

Condition(s): General anaesthesia
Product: MIDAZOLAM, PROPOFOL, ROCURONIUM BROMIDE, Cipepofol Injectable Emulsion, FENTANYL, SEVOFLURANE, PROPOFOL

Primary endpoint: Success rate of general anesthesia induction: A successful general anesthesia induction will meet both of the following conditions: a) Induction success (MOAA/S ≤1) after administration of the study drug, and b) One or less top-up doses required without using any rescue drugs.
Endpoint(s): The proportion of subjects with any injection-site pain at time of drug administration on the Numeric Rating Scale (NRS ≥1)., The proportion of subjects with successful induction who maintain the desired depth of anesthesia for general elective surgery, and without significant cardiac and respiratory depression within 15 minutes post initiation start of study drug administration.

Source: https://euclinicaltrials.eu/ctis-public/view/2023-507009-32-00